EU clinical trial 2024-518090-34-00: Evaluation of safety and efficacy of two ticagrelorbased de-escalation antiplatelet strategies in acute coronary syndrome: the randomized, multicenter, double-blind ELECTRA RCT study.
Protocol code: 2019/ABM/01/00009
Sponsor: Nicolaus Copernicus University (Educational Institution). Phase: Therapeutic confirmatory (Phase III). Countries: Poland (ended).
Therapeutic area(s): Diseases [C] - Cardiovascular Diseases [C14]
Gender: Female, Male. Age: 18-64 years, 65+ years. Enrolment: 4500.
Status: Ended. Start date (EU): 2022-02-07. End date (EU): 2026-04-03. Decision date: 2024-11-24. Results received: No. Last updated: 2024-11-24.

Condition(s): Acute Coronary Syndrom (ACS)
Product: Brilique 90 mg orodispersible tablets, ASPIRIN CARDIO, 100 mg, tabletki powlekane, Brilique 60 mg film-coated tablets, Microcrystalline cellulose, corn starch Coating: copolymer of methacrylic acid and methyl acrylate, polysorbate 80, sodium lauryl sulfate, talc and triethyl citrate

Primary endpoint: The primary end point os this project is the first occurrence of type 2, 3 or 5 bleeding according to the Bleeding Academic Research Consortium (BARC) criteria, within 12 months of observation, in a time-to-event analysis. BARC type 2 bleeding is any clinically overt sign of haemorrhage that is actionable and requires diagnostic studies, hospitalization, or treatment by a health care professional., BARC type 3 bleeding is: a) overt bleeding with haemoglobin drop of 3 to <5 g/dL (provided it is related to bleed); transfusion with overt bleeding;, b) overt bleeding with hemoglobin drop ≥5 g/dL (provided it is related to bleed); cardiac tamponade; bleeding requiring surgical intervention for control; bleeding requiring intravenous vasoactive agents;c) intracranial haemorrhage confirmed by autopsy, imaging, or lumbar puncture; intraocular bleed compromising vision., BARC type 5 bleeding is fatal bleeding.
Endpoint(s): BARC type 3 or 5 bleeding, Thrombolysis in Myocardial Infarction (TIMI) major or minor bleeding, Global Use of Strategies to Open Occluded Coronary Arteries (GUSTO) moderate, severe, or life-threatening bleeding;, International Society of Thrombosis and Haemostasis (ISTH) major bleeding, death from any cause, death from Cardiovascular causes (CV);, myocardial infarction, ischemic stroke, definite or probable stent thrombosis, adherence to study treatment, dyspnea

Source: https://euclinicaltrials.eu/ctis-public/view/2024-518090-34-00